EU clinical trial 2025-524191-38-00: Cholesterol lowering with atorvastatine for the prevention of gallstones following bariatric surgery (CHOLSTONE): an investigator- blinded randomised controlled trial
Protocol code: CHOLSTONE
Sponsor: Spaarne Gasthuis Stichting (Hospital/Clinic/Other health care facility). Phase: Therapeutic use (Phase IV). Countries: Netherlands (authorised, recruitment pending).
Therapeutic area(s): Diseases [C] - Nutritional and Metabolic Diseases [C18]; Diseases [C] - Digestive System Diseases [C06]
Gender: Female, Male. Age: 18-64 years. Enrolment: 202.
Status: Authorised, recruitment pending. Decision date: 2026-03-17. Results received: No. Last updated: 2026-03-17.

Condition(s): Gallstones (chole(cysto)lithiasis) following bariatric surgery
Product: ATORVASTATIN

Primary endpoint: Incidence of gallstone formation six months after bariatric surgery, confirmed by ultrasound examination.
Endpoint(s): Change in plasma LDL-cholesterol levels between baseline and six months after bariatric surgery., Change in fecal and plasma bile acid profiles between baseline and six months after bariatric surgery., Incidence and severity of adverse events related to atorvastatin in the post- bariatric population

Source: https://euclinicaltrials.eu/ctis-public/view/2025-524191-38-00